EU clinical trial 2023-510376-31-00: A phase IIa, randomized, placebo-controlled, double-blind, cross-over study to evaluate safety and efficacy of subcutaneous administration of anakinra in patients with cystic fibrosis (ANAKIN)
Protocol code: ANAKIN
Sponsor: Universitaetsklinikum Heidelberg AöR (Hospital/Clinic/Other health care facility). Phase: Therapeutic exploratory (Phase II). Countries: Germany (ended).
Therapeutic area(s): Diseases [C] - Respiratory Tract Diseases [C08]; Diseases [C] - Congenital, Hereditary, and Neonatal Diseases and Abnormalities [C16]
Gender: Female, Male. Age: 0-17 years, 18-64 years, 65+ years. Enrolment: 60.
Status: Ended. Start date (EU): 2022-10-05. End date (EU): 2026-07-28. Decision date: 2024-01-31. Results received: No. Last updated: 2024-05-16.
Decision dates by country: DE: 2024-05-16

Condition(s): Cystic fibrosis
Product: Kineret Placebo, Kineret 100 mg/0.67 ml solution for injection in pre-filled syringe.

Primary endpoint: Absolute pre-post change of the lung clearance index (LCI).
Endpoint(s): Evaluation of the safety and tolerability of the 28- days-treatment with anakinra by means of: o Physical examination o (Serious) adverse events o Laboratory safety parameters (clinical chemistry, hematology, clotting), Investigation of the effects of anakinra on lung function by means of absolute change in percentage points predicted forced expiratory volume in 1 second (FEV1 and FEV1 % pred)., Evaluation of the impact of anakinra on the quality-of-life (QoL) in the considered population by means of the Cystic Fibrosis Questionnaire – Revised (CFQ-R, German version)., Investigation of the effects of anakinra on lung function by means of absolute change in forced expiratory flow75 in liters/second and percent predicted (FEF75 and FEF75 % pred) and forced vital capacity in liter and percent predicted (FVC and FVC % pred)., Assessment of the influence of anakinra on lung structure and perfusion determined by chest MRI (optional sub-study)., Assessment of the influence of anakinra on airway inflammation by means of the following parameters: o Characterization of immune cells (absolute cell counts) in sputum samples o Inflammatory markers in sputum samples., Assessment of the influence of anakinra on the bronchial infection status by means of sputum microbiology., Assessment of sputum rheology

Source: https://euclinicaltrials.eu/ctis-public/view/2023-510376-31-00